EU clinical trial 2022-500537-84-00: A randomized, double-blind, multicenter phase III study to evaluate the long-term efficacy and safety of ABX464 25 mg or 50 mg once daily as a maintenance therapy in subjects with moderately to severely active ulcerative colitis
Protocol code: ABX464-107
Sponsor: Abivax (Pharmaceutical company). Phase: Therapeutic confirmatory (Phase III). Countries: Belgium (not authorised), Germany (not authorised), Italy (not authorised), Spain (not authorised), Poland (not authorised), France (not authorised).
Therapeutic area(s): Diseases [C] - Digestive System Diseases [C06]
Gender: Female, Male. Age: 0-17 years, 18-64 years, 65+ years. Enrolment: 339.
Status: Not authorised. Decision date: 2022-12-27. Results received: No. Last updated: 2023-01-25.
Decision dates by country: BE: 2023-01-11, FR: 2023-01-19, DE: 2022-12-27, IT: 2023-01-13, ES: 2023-01-11, PL: 2023-01-25

Condition(s): Moderately to severely active ulcerative colitis, Moderately to severely active ulcerative colitis
Product: The placebo for the 25 and 50 mg ABX464 hard capsules., ABX464, ABX464, PLACEBO

Primary endpoint: Proportion of subjects in clinical remission at Week 44.
Endpoint(s): Proportion of subjects with endoscopic improvement at Week 44, Proportion of subjects with symptomatic remission at Week 44, Proportion of subjects with corticosteroid-free clinical remission at Week 44., Proportion of subjects with sustained clinical remission at Week 44., Proportion of subjects with HEMI per Geboes scoring at Week 44, Proportion of subjects with endoscopic remission at Week 44., Incidence of all treatment-emergent adverse events (TEAEs), causally related adverse events (AEs), all serious adverse events (SAEs) and causally related SAEs classified, by severity, Incidence of AEs leading to investigational medicinal product discontinuation and study discontinuation., Incidence of adverse events of special interest (AESIs)., Incidence of clinically significant laboratory abnormalities, Incidence of clinically significant abnormalities regarding vital signs and ECG

Source: https://euclinicaltrials.eu/ctis-public/view/2022-500537-84-00